EU clinical trial 2023-504975-25-00: A phase IV, open, non-randomised, low-intervention clinical trial to evaluate the subjective user experience of Zeqmelit™ 6 mg mouth dissolving film for treatment of acute allergic reaction
Protocol code: ZEQ-001
Sponsor: AcuCort AB (Pharmaceutical company). Phase: Phase III and phase IV (Integrated). Countries: Sweden (ended).
Therapeutic area(s): Diseases [C] - Immune System Diseases [C20]
Gender: Female, Male. Age: 18-64 years, 65+ years. Enrolment: 50.
Status: Ended. Start date (EU): 2024-01-26. End date (EU): 2024-10-24. Decision date: 2023-06-14. Results received: Yes. Last updated: 2023-06-14.

Condition(s): Acute allergic reaction
Product: Isicort 6 mg munsönderfallande film

Primary endpoint: Overall satisfaction in terms of general satisfaction and feeling safe. (Questions: 1f/4h, 2i, 3a-d, 4a-g).
Endpoint(s): User experience in terms of choice of treatment, having access to treatment and other medication. (Questions: 2a-g, 2j-n, 3e-g)., Perceived effectiveness of Zeqmelit™ 6 mg mouth film. (Question: 2h).

Source: https://euclinicaltrials.eu/ctis-public/view/2023-504975-25-00